EU clinical trial 2024-510976-19-00: A Phase III, Randomized, Open-Label, Controlled, Multi-Center, Global Study of First-Line Durvalumab in Combination with Standard of Care Chemotherapy and Durvalumab in Combination with Tremelimumab and Standard of Care Chemotherapy Versus Standard of Care Chemotherapy Alone in Patients with Unresectable Locally Advanced or Metastatic Urothelial Cancer
Protocol code: D933SC00001
Sponsor: AstraZeneca AB (Pharmaceutical company). Phase: Therapeutic confirmatory (Phase III). Countries: Poland (ongoing, recruitment ended), Bulgaria (ongoing, recruitment ended), Czechia (ended), Italy (ongoing, recruitment ended), Spain (ongoing, recruitment ended), Hungary (ongoing, recruitment ended).
Therapeutic area(s): Diseases [C] - Neoplasms [C04]
Gender: Female, Male. Age: 18-64 years, 65+ years. Enrolment: 353.
Start date (EU): 2018-11-30. Decision date: 2024-06-28. Results received: No. Last updated: 2026-07-30.
Decision dates by country: HU: 2024-07-04, ES: 2024-06-28, PL: 2024-07-10, BG: 2024-07-01, CZ: 2024-07-03, IT: 2024-08-05

Condition(s): Patients with Unresectable Locally Advanced or Metastatic Urothelial Cancer
Product: GEMCITABINE, CARBOPLATIN, IMFINZI 50 mg/mL concentrate for solution for infusion., CISPLATIN, GEMCITABINE, MYCOPHENOLATE MOFETIL, IMJUDO 20 mg/ml concentrate for solution for infusion., INFLIXIMAB

Primary endpoint: Overall Survival (OS)
Endpoint(s): Progression Free Survival (PFS) - Overall Survival (OS) - Alive and Progression Free Patients at 12 Months (APF12) - Overall Response Rate (ORR) - Disease Control Rate (DCR) - Duration of Response (DoR) - Time from Randomization to Second Progression PFS (PFS2) - Safety - Disease related symptoms

Source: https://euclinicaltrials.eu/ctis-public/view/2024-510976-19-00